EU clinical trial 2026-525500-10-00: ObStructive Sleep Apnoea ManageMent in Older AdUlts with Overweight or ObEsity: A Randomized ClinicaL Trial (SAMUEL study)
Protocol code: SAMUEL
Sponsor: Institut De Recerca Biomedica De Lleida Fundacio Dr. Pifarre (Laboratory/Research/Testing facility). Phase: Therapeutic use (Phase IV). Countries: Spain (authorised, recruitment pending).
Therapeutic area(s): Diseases [C] - Nutritional and Metabolic Diseases [C18]; Diseases [C] - Respiratory Tract Diseases [C08]
Gender: Female, Male. Age: 65+ years. Enrolment: 345.
Status: Authorised, recruitment pending. Decision date: 2026-06-29. Results received: No. Last updated: 2026-06-29.

Condition(s): Obstructive sleep apnea syndrome, Obesity
Product: Mounjaro 10 mg solution for injection in vial

Primary endpoint: Change from baseline in the Apnea-Hypopnea Index (AHI) at week 24.
Endpoint(s): Change from baseline in the Epworth Sleepiness Scale (ESS) and the Pittsburgh Sleep Quality Index (PSQI) at week 24., Change from baseline in body weight (kg) and Body Mass Index (BMI) at week 24., Change from baseline in the Montreal Cognitive Assessment (MoCA) score at week 24., Incidence and severity of Adverse Events (AEs) and Serious Adverse Events (SAEs) throughout the 24-week period.

Source: https://euclinicaltrials.eu/ctis-public/view/2026-525500-10-00